EU clinical trial 2025-524995-53-00: Reproductive outcomes with letrozole co-treatment during ovarian stimulation in women with endometriosis undergoing IVF/ICSI: a randomised, multicentre, parallel group pragmatic trial
Sponsor: UZ Brussel (Hospital/Clinic/Other health care facility). Phase: Therapeutic use (Phase IV). Countries: Belgium (authorised, recruitment pending).
Therapeutic area(s): Phenomena and Processes [G] - Reproductive and Urinary Physiological Phenomena [G08]
Gender: Female. Age: 18-64 years. Enrolment: 854.
Status: Authorised, recruitment pending. Decision date: 2026-05-13. Results received: No. Last updated: 2026-05-13.

Condition(s): Women with endometriosis undergoing IVF/ICSI
Product: Letrozole Teva 2,5 mg filmomhulde tabletten

Primary endpoint: The primary endpoint is cumulative live birth per stimulation (or IVF/ICSI) cycle, including fresh ET and frozen ETs resulting from the same oocyte aspiration and transferred within 1 year of randomization.
Endpoint(s): LBR per fresh ET cycle (excluding freeze-all), defined as live birth at ≥ 24 weeks of gestation., Number of ETs needed for successful pregnancy, Miscarriage rate (defined as pregnancy loss prior to viability scan and including those confirmed on ultrasound scan up to ≤ 23 weeks 6 days gestation) for fresh and frozen ETs., Implantation rate (positive serum βhCG 10-15 days after transfer) for fresh and frozen ETs., Clinical pregnancy rate (at least one gestational sac 4-6 weeks after transfer) for fresh and frozen ETs., Rate of ectopic pregnancy or pregnancy of unknown location for fresh and frozen ETs., For women achieving a pregnancy > 24 weeks: • Pregnancy related complications: pre-eclampsia and pregnancy-induced hypertension, preterm birth, intrauterine growth restriction, caesarean delivery and obstetric hemorrhage. • Extreme preterm birth (24-28 weeks of gestation) • Still birth and termination of pregnancy • Gestational age at delivery, Birthweight • Neonatal admission and mortality • Major congenital abnormalities, Pain score: NRS 1-10 one to four hours after OPU, Patient QOL measured at the day of fresh embryo transfer (OPU +5) and compared to baseline (FertiQOL)

Source: https://euclinicaltrials.eu/ctis-public/view/2025-524995-53-00